EU clinical trial 2022-500116-18-00: A Phase 1b, Open-Label, Dose-Escalation and Dose-Expansion Study to Evaluate the Safety, Tolerability, Pharmacokinetics, and Antitumor Activity of Mipasetamab Uzoptirine (ADCT-601) Monotherapy and in Combination with Other Anti-Cancer Therapies in Patients with Selected Advanced Solid Tumors
Protocol code: ADCT-601-102
Sponsor: ADC Therapeutics S.A. (Pharmaceutical company). Phase: Human Pharmacology (Phase I)- Other. Countries: France (ended), Spain (ended).
Therapeutic area(s): Diseases [C] - Neoplasms [C04]
Gender: Female, Male. Age: 18-64 years, 65+ years. Enrolment: 135.
Status: Ended. Start date (EU): 2023-01-09. End date (EU): 2025-04-17. End date: 2025-04-18. Decision date: 2022-07-28. Results received: No. Last updated: 2025-01-31.
Decision dates by country: ES: 2022-07-28, FR: 2022-07-28

Condition(s): Advanced Solid Tumors

Source: https://euclinicaltrials.eu/ctis-public/view/2022-500116-18-00